EU clinical trial 2025-524543-12-00: The efficacy of oral vancomycin therapy in managing different phenotypes of paediatric inflammatory bowel diseases by correlating treatment response to commensal microbiota composition and function (VERDA)
Sponsor: Pirkanmaan hyvinvointialue (Hospital/Clinic/Other health care facility). Phase: Therapeutic exploratory (Phase II). Countries: Finland (authorised, recruitment pending).
Therapeutic area(s): Diseases [C] - Digestive System Diseases [C06]
Gender: Female, Male. Age: 0-17 years. Enrolment: 140.
Status: Authorised, recruitment pending. Decision date: 2026-03-24. Results received: No. Last updated: 2026-03-31.

Condition(s): Ulcerative colitis
Product: Vancomycin Xellia 250 mg, kapseli, kova, Vancomycin Xellia 125 mg, kapseli, kova

Primary endpoint: Suolen tervehtyminen (remissio eli lapsi on oireeton ja ulosteen kalprotektiini on alle 100), Miltä suolen bakteeristo näyttää ennen vankomysiinihoitoa tai tavanomaista hoitoa tulehduksen aikana ja remissiossa hoidon aloittamisen jälkeen

Source: https://euclinicaltrials.eu/ctis-public/view/2025-524543-12-00